EU clinical trial 2023-503231-17-00: A Phase III, Randomized, Open-Label, Multicenter, Global Study of Volrustomig (MEDI5752) in Combination with Carboplatin plus Pemetrexed Versus Platinum plus Pemetrexed or Nivolumab plus Ipilimumab in Participants with Unresectable Pleural Mesothelioma (eVOLVE-Meso)
Protocol code: D7988C00001
Sponsor: AstraZeneca AB (Pharmaceutical company). Phase: Therapeutic confirmatory (Phase III). Countries: Norway (ongoing, recruitment ended), France (ongoing, recruitment ended), Germany (ongoing, recruitment ended), Belgium (ongoing, recruitment ended), Spain (ongoing, recruitment ended), Poland (ongoing, recruitment ended), Denmark (ongoing, recruitment ended), Italy (ongoing, recruitment ended), Netherlands (ongoing, recruitment ended).
Therapeutic area(s): Diseases [C] - Neoplasms [C04]
Gender: Female, Male. Age: 18-64 years, 65+ years. Enrolment: 383.
Status: Ongoing, recruitment ended. Start date (EU): 2024-04-26. Decision date: 2023-12-11. Results received: No. Last updated: 2026-04-16.
Decision dates by country: DE: 2023-12-15, ES: 2023-12-14, DK: 2023-12-11, NL: 2023-12-18, PL: 2023-12-14, NO: 2023-12-11, BE: 2023-12-11, FR: 2023-12-15, IT: 2023-12-14

Condition(s): Unresectable Pleural Mesothelioma
Product: CARBOPLATIN, CARBOPLATIN, IPILIMUMAB, PEMETREXED, CISPLATIN, INFLIXIMAB, PEMETREXED, Mycofit, 250 mg, kapsułki twarde, NIVOLUMAB, volrustomig

Primary endpoint: overall survival
Endpoint(s): Overall Survival and Progression Free Survival, OS and PFS at specific landmarks, Overall Response Rate, Duration of Response, and PFS2 (time from randomization to the second progression event)., TTD in physical functioning, change from baseline in disease-related symptoms, and in functioning, Incidence of ADAs against volrustomig., Concentrations of volrustomig and PK parameters as data allow, Safety and tolerability based on AEs, rates of AE-related dose discontinuations/modifications, vital signs, clinical laboratory assessments, physical examinations, and ECGs

Source: https://euclinicaltrials.eu/ctis-public/view/2023-503231-17-00